EU clinical trial 2024-514269-20-00: I4T-MC-JVCY: A Multicenter, Randomized, Double-Blind Study of Erlotinib in Combination with Ramucirumab or Placebo in Previously Untreated Patients with EGFR Mutation-Positive Metastatic Non-Small Cell Lung Cancer
Protocol code: I4T-MC-JVCY
Sponsor: Eli Lilly & Co. (Pharmaceutical company). Phase: Therapeutic confirmatory (Phase III). Countries: Spain (ended).
Therapeutic area(s): Diseases [C] - Neoplasms [C04]
Gender: Female, Male. Age: 18-64 years. Enrolment: 1.
Status: Ended. Start date (EU): 2015-05-06. End date (EU): 2026-02-05. Decision date: 2024-08-21. Results received: No. Last updated: 2025-03-31.

Condition(s): Metastatic Non-Small Cell Lung Cancer
Product: RAMUCIRUMAB, ERLOTINIB

Primary endpoint: Part B (Placebo + Erlotinib): Progression Free Survival (PFS) [ Time Frame: Randomization to Measured Progressive Disease or Death from Any Cause (Up To 37 Months) ], Number of Participants With Treatment-Emergent Adverse Events [ Time Frame: Cycle 1 Day 1 through End of Study (Up To 3 Years) ]

Source: https://euclinicaltrials.eu/ctis-public/view/2024-514269-20-00